EU clinical trial 2024-512672-34-00: Comparison between esketamine nasal spray versus aripiprazole, both in combination with an antidepressant, in the refractory major depression disorder (RMDD) in elderly patients (CESAR)
Protocol code: CESAR
Sponsor: Fundacion Publica Andaluza Para La Gestion De La Investigacion En Salud De Sevilla (Laboratory/Research/Testing facility). Phase: Therapeutic confirmatory (Phase III). Countries: Spain (ongoing, recruiting).
Therapeutic area(s): Psychiatry and Psychology [F] - Mental Disorders [F03]
Gender: Female, Male. Age: 18-64 years, 65+ years. Enrolment: 220.
Status: Ongoing, recruiting. Start date (EU): 2026-02-20. Decision date: 2024-11-26. Results received: No. Last updated: 2025-10-23.
Decision dates by country: ES: 2025-01-08

Condition(s): Refractory major depression disorder (RMDD)
Product: ARIPIPRAZOLE, ARIPIPRAZOLE, ESKETAMINE

Primary endpoint: Clinical response at week 8 after initiation of treatment, measured in terms of: - Remission of depressive symptoms; total score ≤10 on the MADRS scale. - Adequate clinical response, if they show a reduction of ≥50% in the total score of the MADRS scale with respect to the initial score and a score ≤4 on the CGI severity scale.
Endpoint(s): Clinical response at week 32 after initiation of treatment, measured in terms of: - Remission of depressive symptoms; total score ≤10 on the MADRS scale. - Adequate clinical response, if they show a reduction of ≥50% in the total score of the MADRS scale with respect to the initial score and a score ≤4 on the CGI severity scale., Determination of the safety profile of esketamine nasal spray and aripiprazole at week 8, as assessed by the established safety committee, Determination of the safety profile of esketamine nasal spray and aripiprazole at week 32 in those patients who were relapse-free at week 8, as assessed by the established safety committee, Proportion of patients free of relapse at week 24 and week 32 in the group of patients with clinical remission at week 8., Score on the EuroQol-5D (EQ-5D) scale for health-related quality of life in adults, Whole genome sequencing of trial participants using variant filtering and prioritization routinely performed in the HUVR laboratory., Obtaining the transcriptome of trial participants at week 8 and week 32 of treatment using a large-scale sequencer, Integration of participants’ exome and transcriptome findings with other omics., To determine the immune activation and inflammation profiles in both treatment groups, Deep immunophenotyping by flow cytometry of peripheral blood cells in both treatment groups, Determine the activity profiles of relevant pathways in both treatment arms

Source: https://euclinicaltrials.eu/ctis-public/view/2024-512672-34-00